EU clinical trial 2024-510707-11-00: Prostate-only, dose-escalated radiotherapy plus concomitant androgen deprivation therapy in primary localized, NCCN high risk and MMAI classifier low or intermediate-risk prostate cancer – a prospective, single-arm, phase II study
Protocol code: HypoPro
Sponsor: Linac-Pet Scan Opco Limited (Hospital/Clinic/Other health care facility). Phase: Therapeutic exploratory (Phase II). Countries: Cyprus (ongoing, recruiting).
Therapeutic area(s): Diseases [C] - Neoplasms [C04]
Gender: Male. Age: 18-64 years, 65+ years. Enrolment: 30.
Status: Ongoing, recruiting. Start date (EU): 2024-10-21. Decision date: 2024-05-29. Results received: No. Last updated: 2025-02-26.

Condition(s): Prostate cancer
Product: GOSERELIN

Primary endpoint: Disease-free survival 5 years after treatment. Disease recurrence is defined as PSA failure according to Phoenix, new lesions on PSMA PET and/or MRI imaging or the beginning of any salvage therapy.
Endpoint(s): Time to local or regional failure; after end of RT. Local or regional recurrences have to be confirmed by PSMA-PET or mpMR imaging. For the diagnosis of local failure, verification via biopsy is warranted., Metastatic free survival (MFS) after end of RT, (all metastases have to be confirmed by PSMA-PET/CT or mpMR imaging), Overall (OS) and prostate cancer specific (PCSS) survival after end of RT, Time to biochemical failure after end of RT (phoenix definition), Patient reported quality of life (QOL: EPIC-CP, IPSS and IIEF-5), Cumulative acute genitourinary (GU) and gastrointestinal (GI) toxicities during and up to 3 months after RT using the RTOG criteria, Cumulative chronic GU and GI toxicities after RT using the RTOG and CTCAEv5.0 criteria, Testosterone recovery

Source: https://euclinicaltrials.eu/ctis-public/view/2024-510707-11-00